EU clinical trial 2025-521145-24-01: A Phase 1/2, Open-Label Study to Evaluate the Safety and Efficacy of Autologous CD19-specific Chimeric Antigen Receptor T cells (CABA-201) in Subjects with Active Idiopathic Inflammatory Myopathy or Active Juvenile Idiopathic Inflammatory Myopathy
Protocol code: CAB-201-002
Sponsor: Cabaletta Bio Inc. (Pharmaceutical company). Phase: Phase I and Phase II (Integrated)- Other. Countries: Italy (authorised, recruitment pending), Spain (authorised, recruitment pending), Germany (authorised, recruitment pending).
Therapeutic area(s): Diseases [C] - Immune System Diseases [C20]
Gender: Female, Male. Age: 0-17 years, 18-64 years. Enrolment: 13.
Status: Authorised, recruitment pending. Decision date: 2026-04-28. Results received: No. Last updated: 2026-04-30.
Decision dates by country: IT: 2026-04-29, DE: 2026-04-30, ES: 2026-04-28

Condition(s): Active Idiopathic Inflammatory Myopathy including dermatomyositis, anti-synthetase syndrome, immune-mediated necrotizing myopathy or Juvenile Idiopathic Inflammatory Myopathy
Product: Genoxal 1.000 mg polvo para solución inyectable y para perfusión, Fludarabin Accord 25 mg/ml Konzentrat zur Herstellung einer Injektions- /Infusionslösung, Endoxan Baxter 1 g Polvere per soluzione iniettabile, Fludarabina Teva 25 mg/ml concentrado para solución para perfusión o inyección EFG, Fludarabina Teva, concentrato per soluzione iniettabile o per infusione, Endoxan

Primary endpoint: Incidence and severity of AEs
Endpoint(s): Incidence and severity of AEs, including changes in laboratory values and vital signs, Levels of B cells in the blood, Levels of CABA-201-positive T cells in the blood, Levels of muscle enzymes (CK, LDH, AST, ALT, and aldolase) in serum, Levels of autoantibodies from the Myositis-Specific Autoantibody Panel (e.g., MDA-5, Jo-1, and HMGCR) in the serum, Total Improvement Score (0 to 100, with higher scores indicating greater improvement) based on the Core Set Measures

Source: https://euclinicaltrials.eu/ctis-public/view/2025-521145-24-01